EU clinical trial 2025-520516-33-00: Investigation of Drug-Drug Interactions between LVDS (Levonorgestrel Vaginal Delivery System) and Miconazole in Healthy Female Participants.
Protocol code: LR-103
Sponsor: Chemo Research S.L. (Pharmaceutical company). Phase: Human Pharmacology (Phase I)- Other. Countries: Portugal (ended).
Therapeutic area(s): Not possible to specify
Gender: Female. Age: 18-64 years. Enrolment: 21.
Status: Ended. Start date (EU): 2025-05-28. End date (EU): 2025-09-13. Decision date: 2025-05-08. Results received: No. Last updated: 2025-09-17.
Decision dates by country: PT: 2025-05-19

Condition(s): No medical condition.

Source: https://euclinicaltrials.eu/ctis-public/view/2025-520516-33-00